EU clinical trial 2025-524674-42-00: A Phase 2, Randomized, Double-blind, Placebo-Controlled, Single-Center Study to Assess the effects of SUL-238 on High Energy Phosphates with Magnetic Resonance Spectroscopy (31P-MRS) in patients with Early, untreated Parkinson’s Disease (“SHEPHERD” STUDY)
Protocol code: GN-002
Sponsor: Gen Ilac Ve Saglik Urunleri Sanayi Ve Ticaret A.S. (Pharmaceutical company). Phase: Therapeutic exploratory (Phase II). Countries: Netherlands (ongoing, recruiting).
Therapeutic area(s): Diseases [C] - Nervous System Diseases [C10]
Gender: Female, Male. Age: 18-64 years, 65+ years. Enrolment: 45.
Status: Ongoing, recruiting. Start date (EU): 2026-03-05. Decision date: 2026-02-13. Results received: No. Last updated: 2026-02-13.

Condition(s): Parkinson’s Disease
Product: SUL-238, Identical to test product except without active substance

Primary endpoint: The (mean) change from baseline to Week 4 in each active dose group as compared to placebo in the concentration of mitochondria-related brain metabolites (ATP, phosphocreatine and inorganic phosphate), as measured by ³¹P-Magnetic Resonance Spectroscopic (MRS) imaging, in the following regions of interest (ROIs): • Putamen • Substantia Nigra • Motor Cortex
Endpoint(s): Mean change from baseline to Week 4 in each active dose group as compared to placebo in the predefined mitochondria-related plasma targeted metabolomics and quantitative proteomics., To assess safety and tolerability of SUL-238 Parkinson’s Disease Patients. a- Frequency, seriousness and intensity of adverse events (AEs). b- Changes in safety laboratory measurements, c- Clinically significant changes in vital signs d- Clinically significant changes in electrocardiogram (ECG) e- Clinically significant changes in physical and neurological examination.

Source: https://euclinicaltrials.eu/ctis-public/view/2025-524674-42-00